EU clinical trial 2022-500718-24-00: A PHASE 3, MULTICENTER, RANDOMIZED, DOUBLE-BLIND, PLACEBO-CONTROLLED STUDY TO EVALUATE THE EFFICACY AND SAFETY OF OBEXELIMAB IN PATIENTS WITH IGG4-RELATED DISEASE (INDIGO)
Protocol code: ZB012-03-001
Sponsor: Zenas Biopharma (USA) LLC (Pharmaceutical company). Phase: Therapeutic confirmatory (Phase III). Countries: Spain (ongoing, recruitment ended), Germany (ongoing, recruitment ended), Netherlands (ended), Italy (ongoing, recruitment ended), Sweden (ended), Hungary (ended), Poland (ongoing, recruitment ended), France (ongoing, recruitment ended).
Therapeutic area(s): Diseases [C] - Immune System Diseases [C20]
Gender: Female, Male. Age: 18-64 years, 65+ years. Enrolment: 105.
Start date (EU): 2023-06-09. Decision date: 2023-04-18. Results received: No. Last updated: 2026-06-22.
Decision dates by country: SE: 2023-04-21, NL: 2023-04-24, HU: 2023-04-21, ES: 2023-04-24, FR: 2023-04-18, IT: 2023-04-20, PL: 2023-04-24, DE: 2023-04-20

Condition(s): IgG4-Related Disease
Product: Obexelimab, Placebo sterile solution for SC injection

Primary endpoint: RCP: Time to first IgG4-RD flare, defined as the reappearance of previous signs/symptoms or appearance of new signs/symptoms of IgG4-RD that requires initiation of rescue therapy in the opinion of the investigator and the Adjudication Committee (AC), from randomization to Week 52
Endpoint(s): RCP: Time to IgG4-RD flare that requires initiation of rescue therapy, as determined by the investigator, RCP: Number of investigator- and AC-determined flares requiring initiation of rescue therapy from randomization to Week 52, RCP: The proportion of patients achieving complete remission, defined as no AC-determined flare, no treatment for flare, and either an IgG4-RD Responder Index (RI) score of 0 or determination by the investigator that there was no clinical evidence of active disease at Week 52, RCP: Cumulative dose of IgG4-RD GC rescue therapy from randomization to Week 52, RCP: Incidence of adverse events (AEs), serious adverse events (SAEs), and any AEs of special interest (AESIs), as defined by the Common Terminology Criteria for Adverse Events Version 5.0 (CTCAE v5.0)

Source: https://euclinicaltrials.eu/ctis-public/view/2022-500718-24-00